EU clinical trial 2023-506399-28-00: A Multicenter, Randomized, Double-Blind, Placebo- Controlled 52-Week Maintenance and an Open-Label Extension Study of the Efficacy and Safety of Risankizumab in Subjects with Crohn's Disease
Protocol code: M16-000
Sponsor: AbbVie Deutschland GmbH & Co. KG (Pharmaceutical company). Phase: Therapeutic confirmatory (Phase III). Countries: Croatia (ongoing, recruitment ended), Sweden (ended), Poland (ongoing, recruitment ended), Spain (ended), Latvia (ongoing, recruitment ended), Romania (ongoing, recruitment ended), Bulgaria (ended), Slovakia (ongoing, recruitment ended), Norway (ended), Portugal (ongoing, recruitment ended), Denmark (ended), Czechia (ongoing, recruitment ended), France (ended), Estonia (ongoing, recruitment ended), Austria (ended), Netherlands (ended), Germany (ended), Lithuania (ongoing, recruitment ended), Ireland (ended), Italy (ended), Belgium (ongoing, recruitment ended), Greece (ongoing, recruitment ended).
Therapeutic area(s): Diseases [C] - Digestive System Diseases [C06]
Gender: Female, Male. Age: 0-17 years, 18-64 years, 65+ years. Enrolment: 387.
Start date (EU): 2017-11-08. Decision date: 2024-06-19. Results received: No. Last updated: 2026-05-04.
Decision dates by country: IE: 2024-06-19, DK: 2024-06-19, BG: 2024-07-02, ES: 2024-06-24, AT: 2024-08-05, SE: 2024-06-20, NL: 2024-06-20, NO: 2024-06-20, BE: 2024-06-20, HR: 2024-06-21, CZ: 2024-06-20, EE: 2024-06-21, FR: 2024-06-20, DE: 2024-06-20, GR: 2024-07-22, IT: 2024-06-24, LV: 2024-06-20, LT: 2024-07-18, PT: 2024-06-19, RO: 2024-06-21, PL: 2024-07-17, SK: 2024-06-20

Condition(s): Crohn's Disease
Product: Placebo for risankizumab 300mg/3.33ml solution for infusion, ABBV-066 / Risankizumab, Placebo for Risankizumab 90mg/mL Solution for injection in Pre-filled Syringe, Risankizumab, ABBV-066, Risankizumab

Primary endpoint: SS1: Proportion of subjects with clinical remission at Week 52, SS1: Proportion of subjects with endoscopic response at Week 52, SS3: Evaluation of Long-term safety
Endpoint(s): Proportion of participants with clinical remission per Crohn's Disease Activity Index (CDAI) at Week 52, Proportion of subjects with clinical remission at Week 52 among the subjects with clinical remission in Week 0, Proportion of subjects with ulcer-free endoscopy at Week 52, Proportion of subjects with endoscopic remission at Week 52, Mean change of IBDQ total score at Week 52 from baseline of induction, Mean change of FACIT fatigue at Week 52 from baseline of induction, Proportion of subjects who discontinued corticosteroid use for 90 days and achieved clinical remission at Week 52 in subjects taking steroids at baseline (of induction)., Proportion of subjects with CDAI clinical response at Week 52, Proportion of subjects with clinical remission and endoscopic response at Week 52, Proportion of subjects with enhanced clinical response at Week 52, Proportion of subjects with deep remission at Week 52, Exposure adjusted occurrence of CD-related hospitalizations from Week 0 through Week 52, Change from baseline of the induction study in Short Form-36 (SF- 36) Physical Component Summary score at Week 52

Source: https://euclinicaltrials.eu/ctis-public/view/2023-506399-28-00